EU clinical trial 2025-523350-13-02: SHIELD – Swift Hydrocortisone Intervention after trauma exposure
Protocol code: SHIELD
Sponsor: Amsterdam UMC Stichting (Patient organisation/association). Phase: Therapeutic exploratory (Phase II). Countries: Netherlands (authorised, recruitment pending).
Therapeutic area(s): Psychiatry and Psychology [F] - Mental Disorders [F03]
Gender: Female, Male. Age: 18-64 years. Enrolment: 196.
Status: Authorised, recruitment pending. Decision date: 2026-03-17. Results received: No. Last updated: 2026-07-13.

Condition(s): Posttraumatic Stress Disorder (PTSD)
Product: Hydrocortison Hualan 10 mg, tabletten, Placebo pills will be matched in appearance and over-encapsulated with the same capsule as the test medication.

Primary endpoint: PTSD symptom severity at 3 months (T4) after the intervention, measured with the CAPS-5 score.
Endpoint(s): Status of PTSD diagnosis at 3 months (T4) after the intervention, measured with the CAPS-5., Self-reported PTSD symptom severity at 2 weeks (T1), 1 month (T2), 6 weeks (T3), 3 months (T4), 6 months (T5) and 12 months (T6) after the intervention, measured with the PCL-5., Scores on the questionnaires assessing other outcomes (IDS-SR, EQ-5D-5L, AUDIT, ISI) and SAEs at T1 to T6., Demographic data, scores on questionnaires (CTQ, LEC-5), wearable measuring heart rate (HR) and heart rate variability (HRV), intrusion and sleep diary, saliva sample collected at intake, self-composed questionnaires., Results of qualitative interviews with 20 participants of the trial

Source: https://euclinicaltrials.eu/ctis-public/view/2025-523350-13-02